EU clinical trial 2024-514991-41-01: Neo-adjuvant versus Adjuvant chemotherapy in Upper Tract Urothelial Carcinoma: A feasibility phase II randomized clinical trial (“URANUS”)
Protocol code: 2016-004017-27
Sponsor: European Uro-Oncology Group Stichting (Patient organisation/association). Phase: Therapeutic exploratory (Phase II). Countries: Norway (authorised, recruitment pending), Spain (authorised, recruitment pending), Netherlands (authorised, recruitment pending).
Therapeutic area(s): Diseases [C] - Neoplasms [C04]
Gender: Female, Male. Age: 18-64 years, 65+ years. Enrolment: 190.
Decision date: 2024-10-17. Results received: No. Last updated: 2026-05-19.
Decision dates by country: NL: 2024-10-21, NO: 2024-10-18, ES: 2024-10-17

Condition(s): Upper Tract Urothelial Carcinoma. Upper urinary tract transitional cell carcinoma
Product: GEMCITABINE

Primary endpoint: Proportion of UTUC patients randomized to neo or adjuvant chemotherapy that is actually able to start and finalize three courses of planned chemotherapy
Endpoint(s): 1- 2 and 3-year Disease Free Survival (DFS), Overall Survival (OS) and Cancer-Specific Survival (CSS)

Source: https://euclinicaltrials.eu/ctis-public/view/2024-514991-41-01